EU clinical trial 2025-520861-29-00: Higher diagnostic accuracy of 64Cu PET/CT compared to standard 18F-choline PET/CT in the detection rate of metastasis from prostate cancer.
Protocol code: P.64Cu.003.01
Sponsor: A.C.O.M. Advanced Center Oncology Macerata S.r.l. (Pharmaceutical company). Phase: Therapeutic confirmatory (Phase III). Countries: Italy (authorised, recruitment pending).
Therapeutic area(s): Diseases [C] - Neoplasms [C04]; Analytical, Diagnostic and Therapeutic Techniques and Equipment [E] - Diagnosis [E01]
Gender: Male. Age: 18-64 years, 65+ years. Enrolment: 285.
Status: Authorised, recruitment pending. Decision date: 2025-02-24. Results received: No. Last updated: 2025-09-10.

Condition(s): Prostate cancer at risk of developing metastatic lesions
Product: 64Cu(II)Cl2 solution for injection, Fluorocolina (18F) Curium Italy 225 MBq/mL soluzione iniettabile

Primary endpoint: To evaluate the diagnostic performance in terms of sensitivity and specificity of 64Cu PET/CT versus 18F-choline PET/CT on a patient basis, in relation to the whole individual. In particular, 18F-choline PET/CT and 64CuCl2 PET/CT will be evaluated as positive (PET+) in case of evidence of pathological focal uptake in correspondence with site(s) compatible with metastases (bone, lymph node and visceral;otherwise they will be judged negative (PET-) when no pathological focal uptakes are detectable
Endpoint(s): The diagnostic accuracy of the two PET/CT (64Cu and 18F-choline) will be assessed by area under the ROC curve (AUC) and the difference in the curve between the two methods will be evaluated., Sensitivity and specificity on a lesion-based and region-based basis will be analysed by aggregation according to body region (chest, abdomen, pelvis) and anatomo-pathological character of the lesions (bone, lymph node, visceral)., The sensitivity 64Cu PET and 18F-choline will be correlated with PSA levels and calculated as for the primary objective., Patients will be classified into non-metastatic, oligometastatic and multimetastatic with both PET/CT. (A patient with up to three metastases will be defined as oligometastatic)., In each patient the different impact of the two PET scans on decision-making (impact of the test versus pre-test probability) will be assessed with calculation of positive and negative predictive values., In each patient the impact determined by the 64Cu PET/CT on clinical outcome will be evaluated by means of the patient's follow-up data and in particular the consequences of misdiagnosis (delay of treatment or unnecessary intervention) will be assessed., The inter-observer reproducibility of 64CuCl2 and 18F-FCH PET/CT will be evaluated.

Source: https://euclinicaltrials.eu/ctis-public/view/2025-520861-29-00